EU clinical trial 2023-509243-27-00: A Phase 2a, Randomised, Double-Blind, Placebo-Controlled Study to Assess Efficacy and Safety of Atuliflapon Given Orally Once Daily for Twelve Weeks in Adults with Moderate to Severe Uncontrolled Asthma
Protocol code: D7552C00001
Sponsor: AstraZeneca AB (Pharmaceutical company). Phase: Therapeutic exploratory (Phase II). Countries: Poland (ended), Croatia (ended), Bulgaria (ended), Hungary (ended), Germany (ended), Netherlands (ended), Slovenia (ended), Spain (ended), Romania (ended), Slovakia (ended).
Therapeutic area(s): Diseases [C] - Respiratory Tract Diseases [C08]
Gender: Female, Male. Age: 18-64 years, 65+ years. Enrolment: 431.
Status: Ended. Start date (EU): 2023-04-12. End date (EU): 2025-12-29. End date: 2026-01-07. Decision date: 2024-07-16. Results received: No. Last updated: 2026-01-16.
Decision dates by country: SI: 2024-07-19, RO: 2024-09-09, HU: 2024-07-16, HR: 2024-07-19, ES: 2024-07-17, NL: 2024-07-16, SK: 2024-07-17, PL: 2024-08-04, BG: 2024-08-06, DE: 2024-07-22

Condition(s): Moderate-to-Severe Uncontrolled Asthma
Product: Atuliflapon, SALBUTAMOL, Placebo to Atuliflapon

Primary endpoint: Time to first CompEx Asthma event
Endpoint(s): Clinical efficacy endpoints: Change from baseline in: 1 pre-BD FEV1: Week 4, and Week 12 2 SGRQ: Week 4, and Week 12, Clinical efficacy endpoints: Change from Baseline in: 1 ACQ-6: Week 4, 8, 12, and average over the 12-weeks 2 average morning and average evening PEF: Week 4, 8, 12, and average over 12-weeks 3 daily asthma symptom score (total, daytime, and night-time): Week 4, 8, 12, and average over the 12-weeks, Clinical efficacy endpoints: 1 time to first severe asthma exacerbation 2 event status (CompEx Asthma event yes/no), To evaluate the PK of Atuliflapon: 1 Atuliflapon plasma concentrations and PK parameters 2 Atuliflapon plasma concentrations: pre-dose samples at Baseline, Week 4, and Week 12, Safety Endpoints: Safety and tolerability evaluations using AEs, vital sign measures, clinical laboratory assessments, ECG and C-SSRS. For full information please refer to the protocol

Source: https://euclinicaltrials.eu/ctis-public/view/2023-509243-27-00